EU clinical trial 2024-519317-66-00: (ESMERALD) A phase-2A, single-centre, prospective, uncontrolled, open label, single arm, exploratory clinical study to evaluate the safety and efficacy of cutaneous AUP1602-C with foam dressing as a treatment for non-healing neuroischemic diabetic foot ulcers
Protocol code: AT-W-CLI-2024-10
Sponsor: Aurealis Oy (Pharmaceutical company). Phase: Therapeutic exploratory (Phase II). Countries: Italy (authorised, recruitment pending).
Therapeutic area(s): Diseases [C] - Skin and Connective Tissue Diseases [C17]
Gender: Female, Male. Age: 18-64 years, 65+ years. Enrolment: 12.
Status: Authorised, recruitment pending. Decision date: 2025-05-16. Results received: No. Last updated: 2025-05-16.

Condition(s): Diabetic Foot Ulcer

Primary endpoint: Proportion of patients (incidence of) achieving complete wound closure at 20 weeks after starting AUP1602-C treatment., Incidence of local and systemic AEs up to 20 weeks after starting AUP1602-C treatmen, Time to AUP1602-C discontinuation, Proportion of patients withdrawn from AUP1602-C within 12 weeks for reasons other than complete wound closure
Endpoint(s): Time to achieve complete wound closure within 12 and 20 weeks after starting AUP1602-C treatment, Time to >75% wound closure within 12 and 20 weeks after starting AUP1602-C treatment, Time to > 50% wound closure within 12 and 20 weeks after starting AUP1602-C treatment, Proportion of patients achieving complete wound closure (Timeframe: Weeks 4, 8, 12, 16 and 20 after starting AUP1602-C treatment ), Proportion of patients achieving ≥ 40% WAR at 4 weeks after starting AUP1602-C treatment (at FU-V1), Proportion of WAR at 4, 8, 12, 16 and 20 weeks after first AUP1602-C treatment, Proportion of patients with > 75% WAR (Timeframe: Weeks 4, 8, 12, 16 and 20 after first AUP1602-C treatment), Proportion of patients with > 50% WAR (Timeframe: Weeks 4, 8, 12, 16 and 20 after first AUP1602-C treatment), Proportion of wound volume and depth reduction (Timeframe: Weeks 4, 8, 12, 16 and 20 after first AUP1602-C treatment), Proportion of patients with target ulcer recurrence (Timeframe: Weeks 8, 12, 16 and 20 after first AUP1602-C administration, and 6 and 12 months after last AUP1602-C administration), Time to ulcer recurrence (Timeframe: 12 and 20 weeks after starting AUP1602-C, and at 6 and 12 months after last AUP1602-C treatment), Wound healing rate (WAR per week and proportion WAR per week) (Timeframe: Weeks 4, 8, 12, 16 and 20 after first AUP1602-C administration), Proportion of patients with scaring, hypertrophic scaring (keloid) of the wound, and pigmentation of peri-wound skin (Timeframe: Weeks 4, 8, 12, 16 and 20 after first AUP1602-C administration, and 6 and 12 months after last AUP1602-C treatment), Change from baseline in patient’s pain intensity using a numerical rating scale (NRS, ranging from 0 = no pain to 10 = worst imaginable pain) (Timeframe: Weeks 4, 8, 12, 16 and 20 after first AUP1602-C administration), Incidence and prevalence of target ulcer related peri-wound skin maceration events (Timeframe: during run-in period, and Weeks 4, 8, 12, 16 and 20 after first AUP1602-C administration), Incidence and prevalence of target ulcer related local wound infection events (Timeframe: during run-in period, Weeks 4, 8, 12, 16 and 20 after first AUP1602-C administration, and 6 and 12 months after last AUP1602-C administration), Incidence of surgical procedures related to the target ulcer (Timeframe: during run-in period, Weeks 4, 8, 12, 16 and 20 after first AUP1602-C administration, and 6 and 12 months after last AUP1602-C administration, Incidence of target ulcer related amputation events (Timeframe: during run-in period, Weeks 4, 8, 12, 16 and 20 after first AUP1602-C administration, and 6 and 12 months after last AUP1602-C administration), Incidence of local and systemic AEs occuring during the long-term safety FU period, Number of target ulcer related hospital visits during run-in, treatment and efficacy FU periods, Number of patient-days of target ulcer related antibiotic therapy during run-in, treatment and efficacy FU periods, Number of patient-days of hospitalization due to complications related to target ulcer during run-in, treatment and efficacy FU periods

Source: https://euclinicaltrials.eu/ctis-public/view/2024-519317-66-00